EU clinical trial 2024-511944-18-01: PhARMacodynamics of earlY versus Delayed Administration of TIcagrelor during CAngrelor infusion in patients with acute ST-segment elevation Myocardial Infarction: a randomized superiority study
Protocol code: ARMYDA TICA-MI
Sponsor: Azienda Ospedaliero-Universitaria Maggiore Della Carita (Hospital/Clinic/Other health care facility). Phase: Therapeutic use (Phase IV). Countries: Italy (ended).
Therapeutic area(s): Diseases [C] - Cardiovascular Diseases [C14]
Gender: Female, Male. Age: 18-64 years, 65+ years. Enrolment: 50.
Status: Ended. Start date (EU): 2024-10-23. End date (EU): 2026-02-08. Decision date: 2024-08-13. Results received: Yes. Last updated: 2024-08-13.

Condition(s): ST-elevation myocardial infarction (STEMI) undergoing primary percutaneous coronary intervention (PCI)
Product: Kengrexal 50 mg powder for concentrate for solution for injection/infusion, Brilique 90 mg film-coated tablets

Primary endpoint: The primary endpoint is the incidence of high platelet reactivity (HPR), defined as a measured closure time (CT) ≤ 106 seconds, at predefined time points after cangrelor interruption, assessed by platelet function analyzer (PFA)-200 P2Y test, in Early Group compared to Delayed Group.
Endpoint(s): - Difference in mean measured CT. - Incidence of major adverse cardiovascular events (MACE) within 30 days. - Mortality within 30 days. - Incidence of stent thrombosis within 30 days. - Incidence of unplanned revascularization within 30 days. - Incidence of peri-procedural infarction. - Bleeding events according to the BARC criteria.

Source: https://euclinicaltrials.eu/ctis-public/view/2024-511944-18-01